EU clinical trial 2023-505303-23-00: Multicentre, randomised, double-blind, placebo-controlled, 48-week, Phase III trial to evaluate the efficacy and safety of survodutide administered subcutaneously in participants with overweight or obesity and presumed or confirmed nonalcoholic steatohepatitis (NASH)
Protocol code: 1404-0056
Sponsor: Boehringer Ingelheim International GmbH (Pharmaceutical company). Phase: Therapeutic confirmatory (Phase III). Countries: Germany (ended), Spain (ended), Netherlands (ended).
Therapeutic area(s): Diseases [C] - Nutritional and Metabolic Diseases [C18]
Gender: Female, Male. Age: 18-64 years, 65+ years. Enrolment: 16.
Status: Ended. Start date (EU): 2024-07-26. End date (EU): 2025-11-20. End date: 2025-12-02. Decision date: 2024-06-19. Results received: No. Last updated: 2025-10-27.
Decision dates by country: DE: 2024-06-19, NL: 2024-06-20, ES: 2024-06-20

Condition(s): Obesity
Product: BI 456906, BI 456906, BI 456906, BI 456906, Placebo matching products 1 to 7 (pre-filled syringe, filling volume: 0.5 mL), BI 456906, BI 456906, BI 456906

Primary endpoint: Relative reduction in liver fat content of at least 30% from baseline to Week 48 (yes/no) assessed by MRI-PDFF [%], Relative change (%) in body weight [kg] from baseline to Week 48
Endpoint(s): Absolute change from baseline to Week 48 in liver fat content assessed by MRI-PDFF [%], Reduction from baseline to Week 48 in cT1 [ms] levels of ≥80 ms (yes/no), Absolute and relative change from baseline to Week 48 in ALT [U/L] levels, Absolute and relative change from baseline to Week 48 in HOMA-IR (FPI [mlU/L]·FPG [mmol/L]/22.5), Absolute and relative change from baseline to Week 48 in liver stiffness [kPa] assessed by MRE, Absolute and relative change in liver volume [mL] from baseline to Week 48 measured using MRI, Absolute and relative change from baseline to Week 48 in waist circumference [cm], Relative change (%) from baseline to Week 48 in liver fat content assessed by MRI-PDFF [%]

Source: https://euclinicaltrials.eu/ctis-public/view/2023-505303-23-00